EU clinical trial 2024-514676-40-00: An open-label, randomised, single-dose, three-way cross-over trial to assess the pharmacokinetics of NIC24-01 and NIC24-02 oromucosal pouches (a nicotine replacement therapy) in comparison to Nicorette® 4 mg gum in healthy adult smokers under fasted conditions.
Protocol code: 2024-CT-001
Sponsor: Niconovum AB (Pharmaceutical company). Phase: Human Pharmacology (Phase I)- Other. Countries: Sweden (ended).
Therapeutic area(s): Psychiatry and Psychology [F] - Behavioral Disciplines and Activities [F04]
Gender: Female, Male. Age: 18-64 years, 65+ years. Enrolment: 15.
Status: Ended. Start date (EU): 2024-12-12. End date (EU): 2025-01-30. Decision date: 2024-11-21. Results received: No. Last updated: 2024-11-21.

Condition(s): Nicotine dependence

Source: https://euclinicaltrials.eu/ctis-public/view/2024-514676-40-00